EU clinical trial 2024-517630-18-00: Cannabidiol for treatment of non-affective psychosis and cannabis use
Sponsor: Region Hovedstaden (Hospital/Clinic/Other health care facility). Phase: Phase II and Phase III (Integrated). Countries: Denmark (ended).
Therapeutic area(s): Psychiatry and Psychology [F] - Mental Disorders [F03]
Gender: Female, Male. Age: 18-64 years. Enrolment: 64.
Status: Ended. Start date (EU): 2024-10-08. End date (EU): 2025-12-02. Decision date: 2024-10-08. Results received: No. Last updated: 2025-03-11.

Condition(s): Lifetime cannabis use, Non-affective psychosis
Product: Epidyolex placebo, Epidyolex 100 mg/ml oral solution, Risperidon ”Krka”, filmovertrukne tabletter, Risperidon placebo

Primary endpoint: Severity of psychotic symptoms
Endpoint(s): Frequency and quantity of cannabis use by self-reported days of cannabis use per week and amount of use, Cannabis cessation (for current users), defined as no use during the past two weeks (self-reported), Total symptom severity, Symptom response and remission, Global severity of illness, Psychosocial functioning, Neurocognitive functioning, Subjective well-being, Circadian sleep-wake cycle, Subjective sleep quality, Objective sleep evaluation, Metabolomics

Source: https://euclinicaltrials.eu/ctis-public/view/2024-517630-18-00